EU clinical trial 2025-524680-21-00: Intranasal insulin for the prevention of delirium in ICU patients undergoing elective cardiac surgery: a randomized, double blind, placebo controlled pilot trial (INSPIRE)
Sponsor: Radboud universitair medisch centrum Stichting (Hospital/Clinic/Other health care facility). Phase: Phase II and Phase III (Integrated). Countries: Netherlands (ongoing, recruiting).
Therapeutic area(s): Diseases [C] - Nervous System Diseases [C10]
Gender: Female, Male. Age: 65+ years. Enrolment: 30.
Status: Ongoing, recruiting. Start date (EU): 2026-04-29. Decision date: 2026-03-30. Results received: No. Last updated: 2026-03-30.

Condition(s): Delirium
Product: Insulatard 100 international units/ml suspension for injection in vial., Natriumchloride 0,9% oplossing voor injectie

Primary endpoint: 1) Feasibility, 2) tolerability and 3) exploratory efficacy, defined as: 1) Recruitment rate, protocol adherence (number of administered doses divided by number of planned doses), participant retention, follow-up completeness and effectiveness of blinding; 2) Local nasal adverse events (e.g., irritation, epistaxis) and incidence of hypoglycaemia, defined as the number of local nasal adverse events and hypoglycaemia events; 3) Delirium severity (DRS-R-98)
Endpoint(s): Delirium incidence, dichotomous, defined as >= 1 positive delirium assessment(s), Delirium duration, defined as number of days with positive delirium assessment, Delirium and coma-free days, defined as number of days without delirium or coma, Antipsychotic, sedative and benzodiazepine exposure, defined as number of patients receiving antipsychotics, sedatives, or benzodiazepines., Length of ICU and hospital stay, defined as days spent in ICU and hospital, Change in cognitive function, assessed with the modified Telephone Interview for Cognitive Status (TICS m) at baseline (2 weeks prior to hospital admission) and 30 days after surgery

Source: https://euclinicaltrials.eu/ctis-public/view/2025-524680-21-00